EU clinical trial 2023-508590-89-00: A Modular Phase I/II, Open-label, Multicenter Study to Evaluate the Safety, Tolerability, Pharmacokinetics, Immunogenicity, Pharmacodynamics, and Preliminary Efficacy of AZD0305 as Monotherapy or in Combination With Anticancer Agent(s) in Participants with Multiple Myeloma
Protocol code: D7230C00001
Sponsor: AstraZeneca AB (Pharmaceutical company). Phase: Phase I and Phase II (Integrated)- First administration to humans. Countries: Germany (ongoing, recruiting), Spain (ongoing, recruiting), France (ongoing, recruiting).
Therapeutic area(s): Diseases [C] - Neoplasms [C04]
Gender: Female, Male. Age: 18-64 years, 65+ years. Enrolment: 68.
Status: Ongoing, recruiting. Start date (EU): 2024-06-25. Decision date: 2024-05-14. Results received: No. Last updated: 2026-05-13.
Decision dates by country: ES: 2024-05-14, FR: 2024-09-23, DE: 2024-05-14

Condition(s): Multiple Myeloma
Product: POMALIDOMIDE, ELRANATAMAB, AZD0305, ELRANATAMAB

Primary endpoint: Occurrence of dose-limiting toxicities (Phase Ia dose escalation only)., Incidence and severity of AEs and SAEs., these are the core primary endpoints of the study, module specific endpoints are available within the CSP
Endpoint(s): Preliminary efficacy of AZD0305 according to IMWG 2016 response criteria as assessed by investigator, including response endpoints ORR, CRR (module 2 only), DoR, MRD negative CR rate (Modules 2 and 3 only), PFS, and OS., PK parameters of AZD0305 (total ADC), total antibody (conjugated and unconjugated) and MMAE, including but not limited to AUC, Cmax, tmax, clearance, and half-life, as data allow., The number and percentage of participants who develop Anti-Drug Antibody (ADA)., These are the core secondary endpoints of the study, module specific endpoints are available within the CSP

Source: https://euclinicaltrials.eu/ctis-public/view/2023-508590-89-00